EU clinical trial 2025-522939-33-00: Master Protocol Full Title- A Master Protocol for an Exploratory, Phase 2a, Proof-of-Concept Platform Study to Evaluate the Safety, Tolerability, and Efficacy of Multiple Regimens in Participants With Myasthenia Gravis. ISA 2 to Master Protocol ARGX-999-2-MG-2000 – an Exploratory, Phase 2a, Randomized, Double-Blinded, Placebo-Controlled Study to Evaluate the Safety, Tolerability, and Efficacy of Empasiprubart IV Monotherapy in Participants With AChR-Ab Seropositive Generalized Myasthenia Gravis
Protocol code: ARGX-999-2-MG-20002
Sponsor: Argenx (Pharmaceutical company). Phase: Therapeutic exploratory (Phase II). Countries: Greece (authorised, recruitment pending), Italy (authorised, recruitment pending), Germany (authorised, recruitment pending), Belgium (authorised, recruitment pending), Netherlands (authorised, recruitment pending), Spain (authorised, recruitment pending), Poland (authorised, recruitment pending).
Therapeutic area(s): Diseases [C] - Immune System Diseases [C20]
Gender: Female, Male. Age: 18-64 years, 65+ years. Enrolment: 29.
Status: Authorised, recruitment pending. Decision date: 2026-07-08. Results received: No. Last updated: 2026-07-21.
Decision dates by country: BE: 2026-07-08, DE: 2026-07-13, GR: 2026-07-09, IT: 2026-07-10, ES: 2026-07-10, PL: 2026-07-13, NL: 2026-07-21

Condition(s): AChR-Ab Seropositive Generalized Myasthenia Gravis, Myasthenia Gravis, MG, gMG
Product: Placebo to match Empasiprubart IV (ARGX-117), Vyvgart 1 000 mg solution for injection in pre-filled syringe, ARGX-117

Primary endpoint: MP - 1. Incidence, severity, and relatedness of AEs and SAEs, MP - 2. Clinically meaningful changes in vital signs, ECGs, and laboratory parameters, ISA 2 - 1. Incidence, severity, and relatedness of adverse events and serious adverse events in the DBTP, ISA 2 - 2. Clinically meaningful changes in vital signs, electrocardiograms, and laboratory parameters in the DBTP
Endpoint(s): MP - 1. Change in MG disease severity as measured by change from baseline in Myasthenia Gravis Activities of Daily Living (MG-ADL) total score or Myasthenia Gravis Impairment Index (MGII) total score, MP - 2. Proportion of participants reaching minimal symptom expression (MSE) and other percentage improvements at variable time points., ISA 2 - 1. MG-ADL total score change from baseline at week 12, ISA 2 - 2. QMG total score change from baseline at week 12, ISA 2 - 3. MG-ADL total score actual values and changes from baseline over time up to week 12, ISA 2 - 4. QMG total score actual values and changes from baseline over time up to week 12, ISA 2 - 5. Proportion of participants reaching MSE at any point by week 12, ISA 2 - 6. Proportion of participants who have ≥3-point reduction in MG-ADL at week 12, ISA 2 - 7. Proportion of participants who have ≥5-point reduction in QMG at week 12, ISA 2 - 8. Proportion of participants who have a positive PASS at week 12, ISA 2 - 9. Proportion of participants who have a 50% MG-ADL total score improvement at week 12

Source: https://euclinicaltrials.eu/ctis-public/view/2025-522939-33-00